EU clinical trial 2023-506857-40-00: ProBio: An outcome-adaptive and randomised multi-arm biomarker driven study in patients with metastatic prostate cancer
Sponsor: Karolinska Institutet (Educational Institution). Phase: Therapeutic confirmatory (Phase III). Countries: Norway (ongoing, recruiting), Sweden (ongoing, recruiting), Belgium (ongoing, recruiting), Denmark (authorised, recruitment pending), Finland (authorised, recruitment pending).
Therapeutic area(s): Diseases [C] - Neoplasms [C04]
Gender: Male. Age: 18-64 years, 65+ years. Enrolment: 1930.
Start date (EU): 2019-01-08. Decision date: 2024-06-25. Results received: No. Last updated: 2026-06-25.
Decision dates by country: NO: 2024-06-25, BE: 2024-06-26, SE: 2024-06-25, DK: 2026-06-24, FI: 2026-06-25

Condition(s): Prostate Cancer
Product: APALUTAMIDE, ENZALUTAMIDE, NUBEQA 300 mg film-coated tablets, Niraparib tosylate monohydrate+ abiraterone acetate - Film coated tablet- 159.40 mg (eq. 100mg base)+ 500mg, Capivasertib, OLAPARIB, CABAZITAXEL, RADIUM (223RA) DICHLORIDE, Capivasertib, ABIRATERONE, DOCETAXEL, DAROLUTAMIDE, Niraparib tosylate monohydrate + abiraterone acetate - Film coated tablet- 79.90 mg (eq. 50mg base)+ 500mg, BAY 1841788, ABIRATERONE ACETATE

Primary endpoint: Progression-free survival, where progression is defined according to disease stage at trial entry: ● For mHSPC: Time to development of castration-resistance (European Association of Urology [EAU] guidelines) or death ● For mCRPC: Time to no longer clinical benefiting (NLCB) (Prostate Cancer Working Group [PCWG3] guidelines)
Endpoint(s): 1.Overall survival (OS). 2. Quality of life assessed by In all patients enrolled in ProBio: ● EORTC-QLQ-C30 ● EQ-5D-5L ● BPI-SF In patients enrolled in ProBio with ctDNA-undetectable mHSPC: EORTC QLQ-PR25 (hormonal and sexual subdomains). 3. Cost effectiveness will be assessed by using the EQ-5D-5L instrument to estimate health utilities. Treatment costs will be based on drug costs and reimbursement data. 4. Frequency and severity of adverse events (AE).

Source: https://euclinicaltrials.eu/ctis-public/view/2023-506857-40-00